EU clinical trial 2024-511649-21-00: A Phase 2 Study of Zolbetuximab (IMAB362) as Monotherapy and in Combination with Chemotherapy and/or Immunotherapy in Subjects with Metastatic or Locally Advanced Unresectable Gastric or Gastroesophageal Junction (GEJ) Adenocarcinoma and Locoregional Gastric or GEJ Adenocarcinoma Whose Tumors are Claudin (CLDN) 18.2 Positive.
Protocol code: 8951-CL-0103
Sponsor: Astellas Pharma Global Development Inc. (Pharmaceutical company). Phase: Therapeutic exploratory (Phase II). Countries: Italy (ongoing, recruitment ended), France (ongoing, recruitment ended).
Therapeutic area(s): Diseases [C] - Neoplasms [C04]
Gender: Female, Male. Age: 18-64 years, 65+ years. Enrolment: 48.
Status: Ongoing, recruitment ended. Start date (EU): 2018-08-01. Decision date: 2024-05-03. Results received: No. Last updated: 2026-01-23.
Decision dates by country: IT: 2024-05-03, FR: 2024-05-22

Condition(s): Advanced cancer of the stomach or the gastroesophageal junction
Product: ASP8951, Calcium Folinate 10 mg/ml Injection, Oxaliplatin Hospira 5 mg/ml concentrate for solution for infusion, OPDIVO 10 mg/mL concentrate for solution for infusion., Fluorouracil 50mg/ml Injection., OPDIVO 10 mg/mL concentrate for solution for infusion., OPDIVO 10 mg/mL concentrate for solution for infusion.

Primary endpoint: ORR of Zolbetuximab as a single agent by independent review central reader
Endpoint(s): Pharmacokinetics of zolbetuximab (Cohorts 1A, 2, 3A, 4 and 5): AUCinf, AUCinf[%extrap], AUClast, AUCtau, Cmax, Ctrough, tmax, t1/2, tlast,CL, Vz, as appropriate, Pharmacokinetics of oxaliplatin (Cohort 2) and 5-FU (Cohort 2): AUCinf, AUCinf[%extrap], AUClast, Cmax, tmax, t1/2, tlast,CL, Vz, as appropriate, Safety and tolerability of single agent zolbetuximab, in combination with mFOLFOX6 (with or without nivolumab), in combination with pembrolizumab, and in combination with FLOT evaluated by AEs, ECG, vital signs, ECOG performance status and laboratory assessments (NCICTCAE version 4.03), Safety and tolerability of zolbetuximab + FLOT in Cohort 5 include the following additional assessments: surgical complications, surgical mortality as defined by death within 30 days of surgery, percentage of subjects able to complete preoperative chemotherapy, perioperative mortality and morbidity at 30 days and 90 days post last dose, percentage of subjects able to start postoperative chemotherapy, percentage of subjects able to complete postoperative chemotherapy, Immunogenicity of zolbetuximab as a single agent, in combination with mFOLFOX6 (with or without nivolumab), in combination with pembrolizumab and in combination with FLOT as measured by the frequency of anti-drug antibody (ADA) positive subjects, HHRQoL measured by the QLQ-C30, OG-25, GP, EuroQOL Five Dimensions Questionnaire (EQ-5D) and the HRU questionnaires, ORR of zolbetuximab in combination with pembrolizumab and in combination with mFOLFOX6 as assessed by an independent central reader, ORR of zolbetuximab as a single agent, in combination with mFOLFOX6 (with or without nivolumab) and in combination with pembrolizumab by investigator assessment, DCR, DOR and PFS of zolbetuximab as a single agent, in combination with mFOLFOX6 (with or without nivolumab) and in combination with pembrolizumab as assessed by an independent central reader, DCR, DOR and PFS of zolbetuximab as a single agent, in combination with mFOLFOX6 (with or without nivolumab) and in combination with pembrolizumab as assessed by the investigator, OS of zolbetuximab as a single agent, in combination with mFOLFOX6 and nivolumab, and in combination with FLOT, Cohort 5 only: Antitumor activity of zolbetuximab and FLOT as measured by radiological response (restaging) and pathological response ypTNM (pCR), Cohort 5 only: DFS, Cohort 5 only: Minimal residual disease and disease recurrence as measured by circulating tumor DNA (ctDNA)

Source: https://euclinicaltrials.eu/ctis-public/view/2024-511649-21-00